EU clinical trial 2025-523478-17-00: Two initial aflibercept 8 mg loading doses in treatment-naive neovascular AMD
Sponsor: Medical University Of Graz (Educational Institution). Phase: Therapeutic use (Phase IV). Countries: Austria (authorised, recruiting).
Therapeutic area(s): Diseases [C] - Eye Diseases [C11]
Gender: Female, Male. Age: 18-64 years, 65+ years. Enrolment: 50.
Status: Authorised, recruiting. Start date (EU): 2026-03-03. Decision date: 2026-02-16. Results received: No. Last updated: 2026-02-16.

Condition(s): Neovascular age-related macular degeneration
Product: Eylea 114.3 mg/ml solution for injection

Primary endpoint: Proportion of patients without disease activity at week 8.
Endpoint(s): Proportion of patients with a 4, 6, 8, 10, 12, 14 or 16 week treatment interval between the 2nd aflibercept 8 mg loading dose and the 3rd aflibercept 8 mg injection, Change in best corrected visual acuity from baseline to week 4 and 8., Change in central subfield thickness and macular fluid volume from baseline to week 4 and 8., Characteristics/measurements in optical coherence tomography (OCT), optical coherence tomography angiography (OCTA), angiography and best corrected visual acuity (BCVA) assessment, which can predict active/non-active disease.

Source: https://euclinicaltrials.eu/ctis-public/view/2025-523478-17-00